EU clinical trial 2024-517991-39-00: A 4-Week, Double-Blind, Placebo-Controlled, Parallel-Group, Efficacy and Safety Trial of Fluticasone Propionate/Albuterol Sulfate Combination compared to Fluticasone Propionate, Albuterol Sulfate or Placebo delivered by Multidose Dry Powder Inhaler in Participants 12 Years and Older with Asthma
Protocol code: FpA-AS-30093
Sponsor: Teva Branded Pharmaceutical Products R&D LLC (Pharmaceutical company). Phase: Therapeutic confirmatory (Phase III). Countries: Germany (ongoing, recruiting), Czechia (ongoing, recruiting), Poland (ongoing, recruiting), Romania (ended), Bulgaria (ongoing, recruiting), Slovakia (ended).
Therapeutic area(s): Diseases [C] - Respiratory Tract Diseases [C08]
Gender: Female, Male. Age: 0-17 years, 18-64 years, 65+ years. Enrolment: 555.
Start date (EU): 2025-07-22. Decision date: 2025-06-04. Results received: No. Last updated: 2026-07-01.
Decision dates by country: BG: 2025-06-06, PL: 2025-06-08, DE: 2025-06-05, CZ: 2025-06-05, RO: 2025-06-10, SK: 2025-06-04

Condition(s): Asthma
Product: Fluticasone propionate,Salbutamol sulfate, Placebo TEV-56248, ProAir® Digihaler®, Albuterol Sulfate HFA, ArmonAir® Digihaler®

Primary endpoint: Baseline-adjusted post-dose forced expiratory volume in one second (FEV1) area under the effect curve from time zero to 6 hours (AUEC0-6hr) over 4 weeks (FEV1 AUEC0-6hr), Baseline-adjusted trough FEV1at week 4
Endpoint(s): Time to 15% improvement from baseline FEV1 post-dose on day 1., Time to 12% improvement from baseline FEV1 post-dose on day 1., Duration of 15% increase in FEV1 from baseline post-dose on day 1, Asthma Control Questionnaire-6 (ACQ-6) response at week 4 defined as achieving a decrease in score from baseline value of at least 0.5 for participants with a baseline ACQ-6 score of ≥1.5, Asthma Control Test (ACT) score response at week 4 defined as achieving an increase in score from baseline value of at least 3, Occurrence of adverse events during the trial., Occurrence of serious adverse events during the trial., Treatment withdrawal due to treatment-emergent adverse events., Plasma concentration of Fp and ABS at the specified timepoints

Source: https://euclinicaltrials.eu/ctis-public/view/2024-517991-39-00